EU clinical trial 2024-520372-10-00: Resistance training and rapamycin to enhance bone formation in postmenopausal women (STRONGBONE)
Protocol code: 2024-520372-10-00
Sponsor: Odense University Hospital (Hospital/Clinic/Other health care facility). Phase: Therapeutic exploratory (Phase II). Countries: Denmark (ongoing, recruiting).
Therapeutic area(s): Diseases [C] - Musculoskeletal Diseases [C05]
Gender: Female. Age: 65+ years. Enrolment: 148.
Status: Ongoing, recruiting. Start date (EU): 2025-10-08. Decision date: 2025-07-08. Results received: No. Last updated: 2026-03-24.

Condition(s): General healthy elderly women with stable medical conditions
Product: PLACEBO, EVEROLIMUS

Primary endpoint: Percentage change in circulating levels of bone formation marker N-terminal fragment of procollagen type 1 (P1NP) at 24 weeks as compared with baseline
Endpoint(s): Change in circulating levels of bone turnover marker: C-terminal telopeptide of type 1 collagen (CTX) at baseline and 24 weeks, Changes in areal BMD at the lumbar spine (L1-4), total hip and femoral neck measured by dual energy x-ray absorptiometry DXA at baseline and 24 weeks, Changes in volumetric BMD, mass, bone microstructures and estimated strength at distal tibia and radius assessed using high resolution peripheral quantitative computed tomography (HRpQCT) at baseline and 24 weeks, Changes in muscle function, power and strength for upper and lower extremities will be assessed using, Changes in health-related quality of life assessment (SF-12 questionnaire)

Source: https://euclinicaltrials.eu/ctis-public/view/2024-520372-10-00